EU clinical trial 2023-508722-99-00: GROINSS-V III; Groningen International Study on Sentinel node in Vulvar cancer III – a prospective phase 2 treatment trial
Sponsor: Universitair Medisch Centrum Groningen (Hospital/Clinic/Other health care facility). Phase: Therapeutic exploratory (Phase II). Countries: Netherlands (ongoing, recruiting), France (ongoing, recruiting), Sweden (ongoing, recruiting), Belgium (authorised, recruitment pending).
Therapeutic area(s): Diseases [C] - Neoplasms [C04]; Diseases [C] - Female Urogenital Diseases and Pregnancy Complications [C13]; Analytical, Diagnostic and Therapeutic Techniques and Equipment [E] - Therapeutics [E02]
Gender: Female. Age: 18-64 years, 65+ years. Enrolment: 92.
Start date (EU): 2020-11-19. Decision date: 2024-03-12. Results received: No. Last updated: 2025-04-14.
Decision dates by country: NL: 2024-03-12, FR: 2025-01-21, SE: 2025-03-14, BE: 2025-04-14

Condition(s): Vulvar cancer
Product: Cisplatin Accord Healthcare 1 mg/ml concentraat voor oplossing voor infusie, Carboplatin Accord Healthcare 10 mg/ml concentraat voor oplossing voor infusie

Primary endpoint: Groin recurrences
Endpoint(s): Treatment related morbidity, Disease-specific survival, Patient reported quality of life

Source: https://euclinicaltrials.eu/ctis-public/view/2023-508722-99-00